EU clinical trial 2022-502542-28-00: A RANDOMIZED DOUBLE-BLIND PHASE IIA STUDY EVALUATING THE EFFICACY, SAFETY, PHARMACOKINETICS, AND PHARMACODYNAMICS OF CROVALIMAB AS ADJUNCT TREATMENT IN PREVENTION OF VASO-OCCLUSIVE EPISODES (VOE) IN SICKLE CELL DISEASE (SCD)
Protocol code: BO42451
Sponsor: F. Hoffmann-La Roche AG (Pharmaceutical company). Phase: Therapeutic exploratory (Phase II). Countries: Netherlands (ended), Spain (ended), France (ended), Italy (ended).
Therapeutic area(s): Diseases [C] - Hemic and Lymphatic Diseases [C15]
Gender: Female, Male. Age: 0-17 years, 18-64 years. Enrolment: 15.
Status: Ended. Start date (EU): 2021-12-06. End date (EU): 2026-02-25. End date: 2026-04-09. Decision date: 2023-07-17. Results received: No. Last updated: 2025-08-14.
Decision dates by country: FR: 2023-07-20, NL: 2023-07-17, IT: 2023-07-31, ES: 2023-07-17

Condition(s): Sickle Cell Disease

Primary endpoint: Annualized rate of medical facility VOEs (AVR)
Endpoint(s): Annualized rate of home VOE captured by patient report on a handheld device at home, Annualized rate of uncomplicated medical facility VOE, Annualized rate of acute chest syndrome (ACS), Annualized rate of days hospitalized for medical facility VOE, Annualized rate of days hospitalized for treatment of non-VOE complications of SCD, Change in hematologic measures from baseline to Week 49, Time to first medical facility VOE from randomization, Change in urinary albumin-creatinine ratio from baseline to Week 49, Change from baseline to Week 49 in tricuspid regurgitant jet velocity (TRV), Proportion of patients with TRV > 2.5 m/s at Week 49, Change from baseline to Week 49 in Patient-Reported Outcomes Measurement Information System (PROMIS)-Fatigue score in adults

Source: https://euclinicaltrials.eu/ctis-public/view/2022-502542-28-00